EU clinical trial 2023-507705-34-00: A Parallel-Group Treatment, Double-Blind, 2-Arm Study to Investigate the Comparative Efficacy, Safety, and Immunogenicity Between Intravenous AVT16 and Entyvio® in Male and Female Subjects Aged 18 to 80 Years Inclusive with Moderate to Severe Active Ulcerative Colitis
Protocol code: AVT16-GL-C01
Sponsor: Alvotech Swiss AG (Pharmaceutical company). Phase: Therapeutic confirmatory (Phase III). Countries: Croatia (ended), Latvia (ended), Slovakia (ended), Bulgaria (ended), Poland (ended), Romania (ended), Spain (ended), Greece (ended), Hungary (ended), Czechia (ended), Italy (ended).
Therapeutic area(s): Diseases [C] - Digestive System Diseases [C06]
Gender: Female, Male. Age: 18-64 years, 65+ years. Enrolment: 462.
Status: Ended. Start date (EU): 2025-08-29. End date (EU): 2025-10-14. End date: 2025-11-25. Decision date: 2024-08-20. Results received: No. Last updated: 2025-02-05.
Decision dates by country: RO: 2024-08-26, BG: 2024-08-22, LV: 2024-08-20, HR: 2024-08-20, SK: 2024-08-20, ES: 2025-01-21, PL: 2024-08-26, GR: 2025-02-04, HU: 2025-02-04, CZ: 2025-02-05, IT: 2025-01-09

Condition(s): Moderate to Severe Active Ulcerative Colitis
Product: Vedolizumab, Entyvio 300 mg powder for concentrate for solution for infusion, Isotonische Kochsalzlösung Fresenius

Primary endpoint: Clinical Response at Week 6, defined as a reduction in the complete Mayo Clinic score in the rectal bleeding subscore of or an absolute rectal bleeding subscore at Week 6.
Endpoint(s): Clinical Response at Weeks 14, 22, 30, 38, and Week 46 Clinical Response at Week 52 Clinical Remission at Week 6 and Week 52. Clinical Remission at Week 52. Mucosal healing at Week 6 and Week 52 Glucocorticoid-free remissionc at Week 52 Albumin levels at Baseline, Week 6, and Week 52. CRP levels at Baseline, Week 6, and Week 52., Incidence, nature, and severity of AEs, graded according to the current version of the CTCAE; clinical laboratory assessments (hematology, clinical biochemistry, coagulation, inflammatory markers such as the erythrocyte sedimentation rate, urinalysis, and urine microscopy), vital signs, ECG, physical examination findings, targeted physical examination findings, infusion drug-related reactions, and injection site reactions., Titer and frequency of ADA. Frequency of NAb. Serum trough concentration of AVT16 and Entyvio at Weeks 0, 2, 6, 14, 22, 30, 38, 46, and 52.

Source: https://euclinicaltrials.eu/ctis-public/view/2023-507705-34-00